EU clinical trial 2023-505320-54-00: A Multi-centered, Double-blind, Randomized, Placebo-controlled, Parallel Group Phase 2 Study of TEV-56286 for the Treatment of Patients with Multiple System Atrophy (TOPAS-MSA)
Protocol code: TV56286-NDG-20039
Sponsor: Teva Branded Pharmaceutical Products R&D LLC (Pharmaceutical company). Phase: Therapeutic exploratory (Phase II). Countries: Spain (ongoing, recruiting), France (ongoing, recruiting), Germany (ongoing, recruiting), Italy (ongoing, recruiting).
Therapeutic area(s): Diseases [C] - Nervous System Diseases [C10]
Gender: Female, Male. Age: 18-64 years, 65+ years. Enrolment: 196.
Status: Ongoing, recruiting. Start date (EU): 2025-01-30. Decision date: 2024-04-16. Results received: No. Last updated: 2026-07-01.
Decision dates by country: DE: 2024-04-16, ES: 2024-04-16, FR: 2024-08-28, IT: 2024-04-22

Condition(s): Multiple System Atrophy
Product: Emrusolmin, Placebo to match IMP TEV-56286

Primary endpoint: The primary efficacy endpoint (TEV-56286 versus placebo, change from baseline to week 48) is as follows: • For non-EU: modified UMSARS part I score (excluding item 11, item scoring rescaled 0-3) • For EU: total UMSARS score (part I and part II combined)
Endpoint(s): The key secondary endpoints (TEV-56286 versus placebo, change from baseline to week 48) are as follows:•For non-EU:total UMSARS score(part I and part II combined)•For EU:modified UMSARS part I score(excluding item 11, item scoring rescaled 0-3)•UMSARS part I score•Lateral ventricle volume measured by MRI•CGI-S•NfL concentrations in CSF•PGI-S, Safety endpoints include the following: 1. number (%) of participants per adverse event from baseline, Safety endpoints include the following: 2. number (%) of participants who withdraw from the trial due to an adverse event from baseline, Safety endpoints include the following: 4. number (%) of participants with potentially clinically significant vital sign values from baseline, Safety endpoints include the following: 5. number (%) of participants with potentially clinically significant laboratory tests values (hematology and chemistry) from baseline, Safety endpoints include the following: 6. number (%) of participants with potentially clinically significant 12-lead ECG measurements from baseline, Safety endpoints include the following: 3. number (%) of participants who withdraw from treatment due to an adverse event from baseline, The other secondary efficacy endpoints (TEV-56286 versus placebo, change from baseline to week 48) are as follows: • Pons volume measured by MRI • Cerebellar volume measured by MRI • UMSARS part II score • UMSARS part IV score • Two-minute walk test as part of gait assessment • MSA-QoL

Source: https://euclinicaltrials.eu/ctis-public/view/2023-505320-54-00